EU clinical trial 2024-513633-20-00: Radiotherapy in combination with pembrolizumab in patients with PSA persistence or biochemical recurrence after radical prostatectomy due to prostate cancer - Pembro-SRT
Protocol code: MK-3475-C51
Sponsor: Medical Center - University Of Freiburg (Hospital/Clinic/Other health care facility). Phase: Therapeutic exploratory (Phase II). Countries: Germany (ongoing, recruitment ended).
Therapeutic area(s): Diseases [C] - Male Urogenital Diseases [C12]
Gender: Male. Age: 18-64 years, 65+ years. Enrolment: 49.
Status: Ongoing, recruitment ended. Start date (EU): 2022-10-28. Decision date: 2024-08-19. Results received: No. Last updated: 2026-05-22.

Condition(s): recurrent prostate cancer
Product: KEYTRUDA 25 mg/mL concentrate for solution for infusion

Primary endpoint: complete biochemical response defined as a PSA level below limit of detection at week 60 after start of pembrolizumab.
Endpoint(s): radiographic progression-free survival (rPFS) at week 60 after start of pembrolizumab., PSA-nadir level and time to PSA-nadir (TTN), Pembrolizumab exposure: number of administered pembrolizumab doses, ADT: administered concomitant substances, duration, dosage (in high-risk patients only), Time to initiation of subsequent therapy (secondary ADT or novel hormonal agents [NHA]), Functional assessment of cancer therapy - Prostate: FACT-P ver. 4.0 (www.facit.org)

Source: https://euclinicaltrials.eu/ctis-public/view/2024-513633-20-00